EU clinical trial 2023-509440-97-00: A Phase 1/2 Multi-Center Study Evaluating the Safety and Efficacy of KTE-X19 in Pediatric and Adolescent Subjects with Relapsed/Refractory B-precursor Acute Lymphoblastic Leukemia or Relapsed/Refractory BCell Non Hodgkin Lymphoma (ZUMA-4)
Protocol code: KTE-C19-104
Sponsor: Kite Pharma Inc. (Pharmaceutical company). Phase: Human Pharmacology (Phase I)- Other. Countries: Spain (ended), Czechia (ended), France (ended), Italy (ended), Poland (ended), Germany (ended).
Therapeutic area(s): Diseases [C] - Neoplasms [C04]
Gender: Female, Male. Age: 0-17 years, 18-64 years. Enrolment: 23.
Status: Ended. Start date (EU): 2018-09-25. End date (EU): 2026-02-04. End date: 2026-03-25. Decision date: 2024-09-23. Results received: No. Last updated: 2026-02-16.
Decision dates by country: CZ: 2024-09-23, DE: 2024-10-22, IT: 2024-10-29, FR: 2024-10-04, PL: 2024-11-13, ES: 2024-09-23

Condition(s): Relapsed/Refractory B-precursor Acute Lymphoblastic Leukemia (r/r ALL) Relapsed/Refractory B-cell non-Hodgkin lymphoma (r/r NHL)
Product: Tecartus 0.4 - 2 x 10e8 cells dispersion for infusion

Primary endpoint: Phase 1: Incidence of adverse events (AEs) defined as dose-limiting toxicities (DLTs)., Phase 2: a) ALL Cohort: Overall complete remission rate (CR + CRi) per independent review. B)NHL Cohort: ORR per investigator assessment
Endpoint(s): ALL cohort: • Overall complete remission rate (CR + CRi) per investigator assessment, Rate of CR within 3 months per independent review, Duration of remission (DOR), Minimal residual disease (MRD) negative rate, Allogeneic SCT rate, Overall survival (OS), Relapsed-free survival (RFS), Incidence of AEs and Common Terminology Criteria for Adverse Events (CTCAE) grade changes in safety laboratory values, Incidence of anti-KTE-X19 antibodies in blood, Changes over time in patient-reported outcome (PRO) scores (Phase 2 only), NHL cohort: • DOR, OS, Progression-free survival (PFS), Incidence of AEs and CTCAE grade changes in safety laboratory values, Incidence of anti-KTE-X19 antibodies in blood, Changes over time in PRO scores (Phase 2 only)

Source: https://euclinicaltrials.eu/ctis-public/view/2023-509440-97-00